EU clinical trial 2023-506258-19-00: Patient reported outcomes in term of swallowing and quality of life after prophylactic versus reactive percutaneous endoscopic gastrostomy tube placement in advanced head and neck cancer patients treated with definitive chemo-radiotherapy
Protocol code: IJB-RT-HNC-001
Sponsor: Institut Jules Bordet (Hospital/Clinic/Other health care facility). Phase: Therapeutic confirmatory (Phase III). Countries: Belgium (ongoing, recruitment ended).
Therapeutic area(s): Diseases [C] - Neoplasms [C04]
Gender: Female, Male. Age: 18-64 years, 65+ years. Enrolment: 121.
Status: Ongoing, recruitment ended. Start date (EU): 2019-12-11. Decision date: 2023-08-02. Results received: No. Last updated: 2025-10-06.

Condition(s): oropharyngal cancer
Product: IOMEPROL, CISPLATIN, BARIUM SULFATE, FLUDEOXYGLUCOSE (18F)

Primary endpoint: The primary endpoint is the global MDADI score at 6 months after end of treatment.
Endpoint(s): Patient reported outcomes via self-administered questionnaires: HRQOL (EORTC QLQ–C30 and EORTC QLQ-H&N43 module) and FACT-HN, Oral-Oropharyngeal toxicity according to the oral mucositis weekly questionnaire: Head and Neck cancer (OMWQ-NH) completed by the subject, Salivary toxicity according to the xerostomia questionnaire completed by the subject, Incidence, type and severity of all adverse events (AEs) and serious adverse events according to CTCAE version 5.0, Incidence, type and severity of radiotherapy related AEs also according to Radiation Therapy Oncology Group (RTOG) / European Organisation for Research and treatment of Cancer (EORTC) scores, Impact of nutritional status on survival and toxicity outcomes by using, GLIM criteria (Global Leadership Initiative on Malnutrition) criteria and CRP, albumin and pre-albumin, Tumour response after study treatment measured at 3 months by DECT and PET-CT after end of treatment, End of treatment. Subject outcome: loco regional control (LRC), distant recurrence/distant progression (DR/DP), second primary (SP), disease-free survival (DFS), disease specific survival (DSS), overall survival (OS)

Source: https://euclinicaltrials.eu/ctis-public/view/2023-506258-19-00